EU clinical trial 2023-505226-33-00: A multicenter, randomized, blinded, placebo controlled, phase II study to evaluate the safety and efficacy of cell therapy based with artificially expanded CD4+CD25+CD127- regulatory lymphocytes and anti-CD20 antibody in pediatric patients with presymptomatic diabetes type 1 (stage 1)
Protocol code: PTG007DM1preTREG001
Sponsor: Poltreg S.A. (Pharmaceutical company). Phase: Therapeutic exploratory (Phase II). Countries: Poland (ongoing, recruiting).
Therapeutic area(s): Diseases [C] - Nutritional and Metabolic Diseases [C18]; Diseases [C] - Immune System Diseases [C20]
Gender: Female, Male. Age: 0-17 years. Enrolment: 150.
Status: Ongoing, recruiting. Start date (EU): 2025-01-28. Decision date: 2024-07-22. Results received: No. Last updated: 2026-03-23.

Condition(s): Presymptomatic diabetes type 1 (stage 1)
Product: PARACETAMOL, RITUXIMAB, SALINE, Tregs, CLEMASTINE, DIPHENHYDRAMINE

Primary endpoint: Percentage of participants in each group who are still in stage 1 type 1 diabetes mellitus, i.e., presence of autoantibodies and normoglycemia or in stage 2 type 1 diabetes mellitus, i.e., presence of autoantibodies, dysglycemia or stage 3 at the end of the trial., Number of adverse events reported 1 year, 2 years after the first dose of Tregs and at the end of the trial comparing to control arms
Endpoint(s): Pace of diabetes development. Total number of days from the date of diagnosis of stage 2 to the date of onset of full-blown type 1 diabetes mellitus (stage 3 of type 1 diabetes mellitus) in each group (normalized to the number of person/days in each group), C-peptide levels [fasting/post MMTT stimulation (AUC)] 1 year, 2 years after the first dose of Tregs and then annually until the end of the trial comparing to control arms, Daily average dose of insulin per kg body weight (DDI) 1 year, 2 years after the first dose of Tregs, and annually thereafter until the end of the trial in each arm of the trial, Number of participants per arm in remission 1 year, 2 years after the first dose of Tregs, and annually thereafter until the end of the trial, [remission defined as daily insulin dose is less than 0.5U/kg/day with an HbA1c level less than 6.5%], Assessment of the incidence and severity of adverse events associated with the administration of Treg preparation or anti-CD20 antibody, primarily the effects of immunosuppression: incidence of infections of any etiology and de novo tumors detected, Number of days from day 0 to the day of first dysglycemia (stage 2 of type 1 diabetes mellitus) in each group., Cumulative diabetes incidence [only the progression to stage 3 considered as diabetes incidence].

Source: https://euclinicaltrials.eu/ctis-public/view/2023-505226-33-00